EU clinical trial 2025-523120-53-00: Prospective Multicenter Randomized Non-Inferiority Study Comparing 7 Days Versus 14 Days of Antibiotic Treatment for Graft Pyelonephritis in Kidney Transplant Recipients (KTI)
Protocol code: KTI2023
Sponsor: Bellvitge University Hospital, Fundacio Institut D'Investigacio Biomedica De Bellvitge IDIBELL (Hospital/Clinic/Other health care facility, Laboratory/Research/Testing facility). Phase: Phase III and phase IV (Integrated). Countries: Spain (ongoing, recruiting).
Therapeutic area(s): Diseases [C] - Bacterial Infections and Mycoses [C01]
Gender: Female, Male. Age: 18-64 years, 65+ years. Enrolment: 360.
Status: Ongoing, recruiting. Start date (EU): 2026-06-10. Decision date: 2026-03-02. Results received: No. Last updated: 2026-03-02.

Condition(s): Graft pyelonephritis in kidney transplant recipients
Product: CIPROFLOXACIN, CIPROFLOXACIN, CEFTRIAXONE, CEFTRIAXONE

Primary endpoint: Definida a los 90 días de la inclusión por: Mortalidad por cualquier causa, o recurrencia de la pielonefritis del injerto, o reingreso por cualquier causa después del alta hospitalaria por el episodio de pielonefritis.
Endpoint(s): Total days of antibiotics since diagnosis of graft pyelonephritis., Total days of intravenous antibiotics since diagnosis of graft pyelonephritis., Total days of admission since diagnosis of graft pyelonephritis., Number of adverse events and interactions with concomitant treatments during hospitalization and at 90 days after the patient's inclusion in the study., Episodes of catheter-related adverse events during admission and at 90 days after the patient's inclusion in the study., Episodes of Clostridioides difficile at 90 days after the patient's inclusion in the study., Evolution of renal function at 90 days from the patient's inclusion in the study., Episodes of rejection and graft loss within 90 days of the patient's inclusion in the study., Isolated microorganisms and antibiotic sensitivity in control urine cultures at 30 and 90 days after the patient's inclusion in the study.

Source: https://euclinicaltrials.eu/ctis-public/view/2025-523120-53-00